EU clinical trial 2024-518714-31-00: A randomized, phase 3, double-blind, double-dummy, active comparator-controlled multicenter study to evaluate the efficacy and safety of 2 doses of linaprazan glurate compared to lansoprazole in 4 or 8 weeks healing in participants with erosive esophagitis (EE) due to gastroesophageal reflux disease (GERD) of Los Angeles (LA) grades A to D
Protocol code: CX842A2301
Sponsor: Cinclus Pharma Holding AB (publ) (Pharmaceutical company). Phase: Therapeutic confirmatory (Phase III). Countries: Germany (ongoing, recruitment ended), Poland (ongoing, recruitment ended), Hungary (ongoing, recruitment ended), Bulgaria (ongoing, recruitment ended), Romania (ongoing, recruitment ended), Czechia (ongoing, recruitment ended).
Therapeutic area(s): Diseases [C] - Digestive System Diseases [C06]
Gender: Female, Male. Age: 18-64 years, 65+ years. Enrolment: 411.
Status: Ongoing, recruitment ended. Start date (EU): 2025-10-03. Decision date: 2025-08-22. Results received: No. Last updated: 2026-06-30.
Decision dates by country: DE: 2025-08-27, CZ: 2025-08-22, PL: 2025-08-26, RO: 2025-08-27, BG: 2025-08-27, HU: 2025-08-26

Condition(s): Erosive esophagitis (EE) due to gastroesophageal reflux disease (GERD)
Product: Placebo to match Linaprazan glurate 50mg, Linaprazan glurate, Placebo to match Lansoprazole 30 mg, LANSOPRAZOLE

Primary endpoint: Healing of EE at Week 4 as assessed by endoscopy in participants with Baseline EE LA grades C/D.
Endpoint(s): 1. Cumulative healing of EE at Week 8 as assessed by endoscopy at 4 and 8 weeks., 2. Healing of EE at Week 4 as assessed by endoscopy., 3. Percentage of 24-hour heartburn-free days from Baseline to Week 8 based on the electronic Diary., 4. Percentage of 24-hour heartburn-free days from Baseline to Week 4 based on the electronic Diary., 5. Cumulative healing of EE at Week 8 as assessed by endoscopy at 4 and 8 weeks in participants with Baseline EE LA grades C/D., 6. Healing of EE at Week 4 as assessed by endoscopy in participants with Baseline EE LA grades C/D., 7. Change in weekly mean 24-hour heartburn severity from Baseline to Week 1, Week 4, and Week 8 based on electronic Diary., 8. Safety analysis based on frequency and severity of adverse events (AEs) and any other safety signals detected.

Source: https://euclinicaltrials.eu/ctis-public/view/2024-518714-31-00